EU clinical trial 2025-521709-42-00: Clinical trial to evaluate the efficacy and safety of Depigoid DUO Grass-Mix/Olea (1000 DPP/mL + 1000 DPP/mL) compared with placebo in patients suffering from allergic rhinoconjunctivitis with or without asthma due to clinically relevant sensitisation to grass and olive pollen.
Protocol code: 060018-PG-PSC-217
Sponsor: LETI Pharma S.L.U. (Pharmaceutical company). Phase: Therapeutic confirmatory (Phase III). Countries: Spain (ongoing, recruiting), Portugal (authorised, recruiting).
Therapeutic area(s): Diseases [C] - Immune System Diseases [C20]; Diseases [C] - Respiratory Tract Diseases [C08]
Gender: Female, Male. Age: 0-17 years, 18-64 years, 65+ years. Enrolment: 343.
Start date (EU): 2026-06-23. Decision date: 2026-03-25. Results received: No. Last updated: 2026-07-02.
Decision dates by country: PT: 2026-03-25, ES: 2026-03-25

Condition(s): Allergic rhinoconjunctivitis with or without asthma due to clinically relevant sensitisation to grass and olive pollen.
Product: Conjunctival Provocation Test Olea europaea LETI 30 HEP/ml, Conjunctival Provocation Test Grass-Mix LETI 30 HEP/ml, Depigoid DUO Grass-Mix/Olea (1000 DPP/ml + 1000 DPP/ml), PLACEBO (Depigoid): the placebo is the solvent used in the investigational medicinal products’ (IMP) formulation. The resulting product is a suspension.

Primary endpoint: Mean cSMS (0-6) at peak grass and olive pollen season comparing active and placebo groups after at least 8 injections of treatment. - Medication score: 0 no medication, 0.5 antihistamine eye drops, 1 oral antihistamine, 1.5 intranasal corticoid - Symptom score: 0 none, 1 mild, 2 moderate, 3 severe: runny nose, sneezing, itchy nose, nasal congestion, itchy eyes, and tearing
Endpoint(s): Absolute values and changes from baseline (if applicable) during active pollen season comparing active and placebo groups after at least 8 injections: -Mean cSMS during the whole grass and olive pollen season -Asthma symptoms and asthma medication score -Severity of rhinoconjunctivitis (ARIA) and asthma (GINA) -QoL (RQLQ/pRQLQ/ AdolRQLQ, AQLQ/PAQLQ)-ESPIA-VAS-ACT..Please refer to the Protocol for further details, In the subset of participants with asthma, during the pollen peak and throughout the pollen season:-Lung function measured by FEV1 when possible-Quality of life measured by the AQLQ for adults or the paediatric version (PAQLQ)-Asthma control measured by the ACT for adults or the paediatric version (pACT)-Asthma severity as classified by the GINA guidelines -Asthma exacerbations (Number,severity, and duration), Total and specific IgE and IgG4 (through InmunoCAP) to Grass-Mix and Phleum pratense, Phl p1, Phl p5, and Olea europaea, Olee1, Total IgA2

Source: https://euclinicaltrials.eu/ctis-public/view/2025-521709-42-00